EU clinical trial 2025-523521-18-00: C6461003 - AN INTERVENTIONAL, PHASE 3, DOUBLE-BLIND, RANDOMIZED STUDY TO EVALUATE THE EFFICACY AND SAFETY OF PF-08634404 IN COMBINATION WITH CHEMOTHERAPY VERSUS BEVACIZUMAB IN COMBINATION WITH CHEMOTHERAPY IN TREATMENT-NAÏVE PARTICIPANTS WITH METASTATIC COLORECTAL CANCER
Protocol code: C6461003
Sponsor: Pfizer Inc. (Pharmaceutical company). Phase: Therapeutic confirmatory (Phase III). Countries: Spain (ongoing, recruiting), Belgium (ongoing, recruiting), France (ongoing, recruiting), Italy (ongoing, recruiting), Netherlands (authorised, recruitment pending), Germany (ongoing, recruiting), Poland (ongoing, recruiting), Denmark (authorised, recruitment pending).
Therapeutic area(s): Diseases [C] - Neoplasms [C04]
Gender: Female, Male. Age: 18-64 years, 65+ years. Enrolment: 220.
Start date (EU): 2026-06-09. Decision date: 2026-03-23. Results received: No. Last updated: 2026-06-29.
Decision dates by country: NL: 2026-06-12, IT: 2026-03-25, DK: 2026-06-08, DE: 2026-06-10, PL: 2026-06-12, FR: 2026-06-08, BE: 2026-03-26, ES: 2026-03-27

Condition(s): Metastatic Colorectal Cancer
Product: OXALIPLATIN, BEVACIZUMAB, PF-08634404, FLUOROURACIL, CALCIUM FOLINATE

Primary endpoint: PFS by BICR, OS
Endpoint(s): • PFS by investigator • ORR by BICR and by investigator • DOR by BICR and by investigator • PFS2 (PFS after next-line therapy) by investigator, • AEs as characterized by type, frequency, severity (as graded by NCI CTCAE v5.0), timing, seriousness, and relationship to study intervention. • Laboratory test abnormalities as characterized by type, frequency, severity (as graded by NCI CTCAE v5.0), and timing., • Predose and postdose concentrations of PF-08634404, • Incidence of ADA against PF-08634404, • Mean score change from baseline in participant reported GHS/QoL, function, and symptoms per EORTC QLQ-C30 • Mean score change from baseline in participant reported function and symptoms scales per EORTC QLQ-CR29, • Time to definitive deterioration in participant reported GHS/QoL, function and symptoms per EORTC QLQ-C30 • Time to definitive deterioration in participant reported function and symptoms per EORTC QLQ-CR29

Source: https://euclinicaltrials.eu/ctis-public/view/2025-523521-18-00